EU clinical trial 2024-517787-29-00: Metformin Intervention in children and adolescents with obesity. A parallel, three arms, randomized, 6 months, multi-center study with metformin extended release (XR) plus lifestyle or metformin immediate release (IR) plus lifestyle or lifestyle alone.
Protocol code: MINT
Sponsor: Region Uppsala (Hospital/Clinic/Other health care facility). Phase: Therapeutic exploratory (Phase II). Countries: Sweden (ended).
Therapeutic area(s): Diseases [C] - Nutritional and Metabolic Diseases [C18]
Gender: Female, Male. Age: 0-17 years. Enrolment: 90.
Status: Ended. Start date (EU): 2021-09-09. End date (EU): 2025-05-06. Decision date: 2024-10-08. Results received: Yes. Last updated: 2024-10-08.

Condition(s): Children and Adolscents with obesity.
Product: GLUCOPHAGE 500 mg film-coated tablets, Glucophage SR 500mg prolonged release tablet

Primary endpoint: BMI-SDS (according to WHO).
Endpoint(s): 1 and 3: BMI-SDS (according to WHO)., 2. Adverse Events, vital signs (systolic and diastolic blood pressure (SBP and DBP) and heart rate), physical examination, fP-glucose, ALAT, creatinine, lactate, cobalamin, clinical chemistry, haematology and urine analysis and plasma metformin concentration., 4. Plasma and urine concentration of metformin (PK), area under the curve (AUC), BMI-SDS (according to WHO)., 5. Demographics, tanner stage, anthropometrics and growth chart. Plasma and urine concentration of metformin (PK), area under the curve (AUC) and BMI-SDS (according to WHO)., 6. Glucose and insulin at fasting and during OGTT. Insulin secretion and sensitivity derived from OGTT. HbA1c., 7. Triglycerides, Total cholesterol, High-Density Lipoprotein (HDL), Low-Density Lipoprotein (LDL), SBP and DBP., 8. Creatinine, Cystatin C/GFR, Alanine Aminotransferase (ALAT), Gamma Glutamyl Transpeptidase (GGT), Lactate Dehydrogenase (LD) and Bilirubin., 9. Hs-CRP., 10. IGF-1, SHBG, FSH, LH, Testosterone and Estrogen., 11. Anthropometrics, waist- and hip circumference (including ratio), and sagittal abdominal diameter (SAD). Bioimpedance, indirect calorimetry and skin fold measurement will be performed at selected sites, 12. Questionnaires: Food Frequency (FFQ), Regular meals, Portion Size, Physical Activity, Medipal®., 13. PedsQL™.

Source: https://euclinicaltrials.eu/ctis-public/view/2024-517787-29-00